EU clinical trial 2024-516355-41-00: A 12-week randomized, participant and investigator blinded, placebo-controlled, exploratory study in adult participants with Chronic Urticaria to assess the efficacy and safety and explore the Mechanism of Action of remibrutinib (LOU064)
Protocol code: CLOU064M12101
Sponsor: Novartis Pharma AG (Pharmaceutical company). Phase: Therapeutic exploratory (Phase II). Countries: Poland (ongoing, recruiting), France (ongoing, recruiting), Germany (ongoing, recruiting), Spain (ongoing, recruiting).
Therapeutic area(s): Diseases [C] - Immune System Diseases [C20]
Gender: Female, Male. Age: 18-64 years, 65+ years. Enrolment: 39.
Status: Ongoing, recruiting. Start date (EU): 2025-06-30. Decision date: 2025-05-19. Results received: No. Last updated: 2026-06-10.
Decision dates by country: FR: 2025-05-19, DE: 2025-05-21, ES: 2025-05-26, PL: 2025-05-25

Condition(s): Chronic Inducible urticaria and Chronic Spontaneous Urticaria
Product: Placebo to LOU064 Film-coated tablet, LOU064

Primary endpoint: Absolute change from baseline in the weekly most bothersome symptom Numeric Rating Scale (NRS) score on the Urticaria Symptom Daily Diary (USDD) at Week 6, Absolute change from baseline in Urticaria Control Test 7 (UCT7) weekly scores at Week 6
Endpoint(s): Absolute change from baseline in Urticaria Control test 7 (UCT7) weekly scores at Week 2 and Week 12, Dermatology Life Quality Index (DLQI) response defined as DLQI= 0-1 at Week 2, Week 6 and Week 12, Absolute change from baseline in USDD weekly component scores at Week 2, Week 6 and Week 12; this includes the change in itch, pain and burning NRS from baseline., Safety endpoints will include but not be limited to: • Occurrence of treatment emergent adverse events (AEs) • Occurrence of treatment emergent serious adverse events (SAEs) • Occurrence of treatment emergent adverse events of special interest (AESIs)

Source: https://euclinicaltrials.eu/ctis-public/view/2024-516355-41-00